EU clinical trial 2022-500491-53-00: A Phase IIa, Randomized, Open-label, Proof-of-Concept Study to Evaluate Safety, Tolerability and Efficacy of Ir CPI in Patients with Spontaneous Intracerebral Haemorrhage - the BIRCH study
Protocol code: Clin_IrCPI_201
Sponsor: Bioxodes (Pharmaceutical company). Phase: Therapeutic exploratory (Phase II). Countries: Belgium (ended).
Therapeutic area(s): Diseases [C] - Nervous System Diseases [C10]
Gender: Female, Male. Age: 18-64 years, 65+ years. Enrolment: 32.
Status: Ended. Start date (EU): 2023-07-27. End date (EU): 2026-06-22. Decision date: 2023-02-06. Results received: No. Last updated: 2025-10-01.

Condition(s): Spontaneous intracerebral haemorrhage
Product: IXODES RICINUS CONTACT PHASE INHIBITOR

Primary endpoint: Adverse event/SAE monitoring, ECGs, Vital signs, Physical examinations and neurological evaluations, Biochemistry, haematology, coagulation (aPTT)
Endpoint(s): Change from baseline in PHO and haemorrhage volumes measured by CT scan, Change from baseline in Ir-CPI plasma concentrations, Change from baseline in aPTT ratio, residual FXI and FXII activities and percentages of inhibition of FXI and FXII procoagulant activities

Source: https://euclinicaltrials.eu/ctis-public/view/2022-500491-53-00